EU clinical trial 2023-505778-14-00: A double-blind, placebo-controlled, randomised phase 1/2a study to evaluate the safety, tolerability and pharmacokinetics of single and repeated subcutaneous ascending-doses of DX243 in healthy volunteers followed by an extension to assess 1-month safety and preliminary efficacy in patients with mild age-related hearing loss.
Protocol code: DX243-101
Sponsor: Dendrogenix (Pharmaceutical company). Phase: Phase I and Phase II (Integrated)- First administration to humans. Countries: Belgium (ongoing, recruiting).
Therapeutic area(s): Diseases [C] - Nervous System Diseases [C10]
Gender: Female, Male. Age: 18-64 years, 65+ years. Enrolment: 116.
Status: Ongoing, recruiting. Start date (EU): 2023-09-19. Decision date: 2023-08-23. Results received: No. Last updated: 2026-06-19.

Condition(s): Age related hearing loss

Source: https://euclinicaltrials.eu/ctis-public/view/2023-505778-14-00